EU clinical trial 2023-508654-26-00: Efficacy and safety of SAR441344 in the treatment of Systemic Lupus Erythematosus: A randomized, double blind, placebo-controlled, Phase 2, proof of concept study.
Protocol code: ACT17010
Sponsor: Sanofi-Aventis Recherche & Developpement (Pharmaceutical company). Phase: Therapeutic exploratory (Phase II). Countries: Spain (ended), Greece (ongoing, recruitment ended), Italy (ended), Hungary (ended).
Therapeutic area(s): Diseases [C] - Musculoskeletal Diseases [C05]
Gender: Female, Male. Age: 18-64 years, 65+ years. Enrolment: 44.
Start date (EU): 2022-03-15. Decision date: 2024-01-24. Results received: No. Last updated: 2026-03-04.
Decision dates by country: ES: 2024-01-29, IT: 2024-02-08, GR: 2024-03-15, HU: 2024-01-24

Condition(s): Systemic lupus erythematosus
Product: Frexalimab, Matched Placebo for Test

Primary endpoint: Percentage of participants who achieved a Systemic Lupus Erythematosus Responder Index (SRI-4) response at Week 24.
Endpoint(s): Percentage of participants who achieved an SRI-4 response in prespecified BM subgroups at Week 24, Percentage of participants who achieved a BILAG–based Composite Lupus Assessment (BICLA) response in prespecified BM subgroups at Week 24, Percentage of participants who achieved a BICLA response at Week 24, ercentage of participants whose prednisone dose was ≤ 7.5 mg at Week 16 and maintained through Week 24 in the subgroup with baseline prednisone ≥10 mg/day, Total cumulative corticosteroid dose over 24 weeks, Percentage of participants achieving an SRI-4 response at week 24 with sustained reduction of oral corticosteroids, Percent change from baseline in percentage in Cutaneous Lupus Erythematosus Disease Area and Severity Index (CLASI)-A at Week 24 in the subgroup of participants with baseline CLASI-A score ≥8, Percentage of participants with ≥50% improvement in CLASI-A at Week 24 in the subgroup of participants with baseline CLASI-A score ≥8, Percentage of participants with ≥50% improvement in the number of tender and swollen joints at Week 24 (among participants with at least 4 joints affected at baseline), Incidence of treatment-emergent AEs (TEAEs), serious AEs (SAEs), and AEs of special interest (AESIs) from Baseline to Week 36 End of Study (EoS), Incidence of study investigational medicinal product permanent discontinuations and study withdrawals due to TEAEs from Baseline to Week 36 (EoS), Participants with medically significant changes in vital signs, electrocardiogram (ECG), and/or laboratory evaluation, Measurement of anti-drug antibodies (ADA) (before administration at Week 0, 4, 8, 12, 16, 20, 24 and after treatment discontinuation at Week 36), SAR441344 concentrations over time, Pharmacokinetic parameters: maximum concentration (Cmax), Pharmacokinetic parameters: time to Cmax (tmax), Pharmacokinetic parameters: area under the curve over the dosing interval (AUC0-tau), Pharmacokinetic parameters: terminal half-life (t1/2z).

Source: https://euclinicaltrials.eu/ctis-public/view/2023-508654-26-00